EU clinical trial 2024-512297-96-01: Carboplatin + Paclitaxel + Cetuximab (PCC) after failure of first line Immune checkpoint inhibitor with or without chemotherapy in recurrent/metastatic squamous cell carcinoma of the head and neck: CARPACCIO (CARboplatin PAClitaxel Cetuximab IO immuno-oncology)
Sponsor: Centre Regional Lutte Contre Le Cancer (Hospital/Clinic/Other health care facility). Phase: Therapeutic exploratory (Phase II). Countries: France (ongoing, recruiting).
Therapeutic area(s): Diseases [C] - Neoplasms [C04]
Gender: Female, Male. Age: 18-64 years, 65+ years. Enrolment: 46.
Status: Ongoing, recruiting. Start date (EU): 2024-11-26. Decision date: 2024-10-30. Results received: No. Last updated: 2026-01-16.

Condition(s): Head and neck squamous cell carcinoma
Product: PACLITAXEL AHCL 6 mg/ml, solution à diluer pour perfusion, Erbitux 5 mg/mL solution for infusion, CARBOPLATINE HOSPIRA 10 mg/ml, solution injectable pour perfusion

Primary endpoint: Number of patients who had an objective response within 12 months
Endpoint(s): Progression events (loco-regional progression, metastatic progression or death whatever the cause) will be collected beyond 12 months of patient participation according to local practices., The patient's condition (alive, deceased from whatever cause or lost to follow-up) will be collected beyond 12 months of patient participation. Patients alive at the time of analysis will be censored on the date of last contact, Time from date of first documented response (complete or partial response) to date of first subsequent progression or death from any cause, Incidence of treatment-emergent adverse events, serious adverse events according to CTCAE V5.0 criteria and deaths, Taking the QLQ-C30 and QLQ-HN35 questionnaires

Source: https://euclinicaltrials.eu/ctis-public/view/2024-512297-96-01